EU clinical trial 2022-500138-27-01: A Phase 3b, Multicenter, Open-label, Daratumumab Long-term Extension Study
Protocol code: 54767414MMY3030
Sponsor: Janssen - Cilag International (Pharmaceutical company). Phase: Therapeutic confirmatory (Phase III). Countries: Germany (ongoing, recruitment ended), Spain (ongoing, recruitment ended), France (ongoing, recruitment ended), Belgium (ongoing, recruitment ended), Denmark (ended), Greece (ongoing, recruitment ended), Italy (ended), Poland (ended), Czechia (ongoing, recruitment ended).
Therapeutic area(s): Diseases [C] - Neoplasms [C04]
Gender: Female, Male. Age: 18-64 years, 65+ years. Enrolment: 70.
Start date (EU): 2023-02-28. Decision date: 2022-11-16. Results received: No. Last updated: 2026-07-28.
Decision dates by country: IT: 2024-05-20, PL: 2024-05-06, DK: 2023-10-09, GR: 2023-12-22, BE: 2023-10-02, DE: 2022-11-17, CZ: 2025-09-24, ES: 2022-11-29, FR: 2022-11-16

Condition(s): Multiple Myeloma
Product: Imnovid 4 mg hard capsules, DARZALEX 1800 mg solution for injection, LENALIDOMIDE, DEXAMETHASONE, Dexamethason 4 mg JENAPHARM®, DARZALEX 20 mg/mL concentrate for solution for infusion, Kyprolis 60 mg powder for solution for infusion, LENALIDOMIDE, LENALIDOMIDE, LENALIDOMIDE, LENALIDOMIDE, DARZALEX 20 mg/mL concentrate for solution for infusion, Imnovid 4 mg hard capsules, DEXAMETHASONE SODIUM PHOSPHATE

Primary endpoint: Primary endpoint is when no more patients require continued access to Daratumumab via this study, which means they have discontinued study treatment or have other alternative access to Daratumumab.

Source: https://euclinicaltrials.eu/ctis-public/view/2022-500138-27-01